EU clinical trial 2025-522216-17-00: A multi-part, adaptive, Phase 1, first time in human study in healthy participants and participants with atopic dermatitis (AD) to assess the safety, tolerability, pharmacokinetics (PK) of single ascending (SAD), multiple ascending doses (MAD) and selected dose of SYX-5219 (AD Participants)
Protocol code: SYX-5219-101
Sponsor: Sitryx Therapeutics Limited (Pharmaceutical company). Phase: Human Pharmacology (Phase I)- First administration to humans. Countries: Germany (ongoing, recruitment ended), Bulgaria (ended), Ireland (ended), Denmark (ongoing, recruitment ended).
Therapeutic area(s): Diseases [C] - Skin and Connective Tissue Diseases [C17]
Gender: Female, Male. Age: 18-64 years. Enrolment: 28.
Start date (EU): 2026-01-26. Decision date: 2025-10-09. Results received: No. Last updated: 2026-06-12.
Decision dates by country: DK: 2026-04-27, BG: 2025-10-21, IE: 2025-10-24, DE: 2025-10-09

Condition(s): Atopic Dermatitis

Source: https://euclinicaltrials.eu/ctis-public/view/2025-522216-17-00